EU clinical trial 2024-513639-26-00: A Study to Investigate Single Ascending Doses of Ocrelizumab for Safety and Side Effects, How The Body Handles It Over A Period of Time, How The Body Notices and Reacts To It, And Its Effect On The Body When Given As A Subcutaneous Injection In Patients With Multiple Sclerosis
Protocol code: WN45319
Sponsor: F. Hoffmann-La Roche AG (Pharmaceutical company). Phase: Human Pharmacology (Phase I)- Other. Countries: Belgium (ended), France (ended), Czechia (ended), Spain (ended), Poland (ended).
Therapeutic area(s): Diseases [C] - Immune System Diseases [C20]; Diseases [C] - Nervous System Diseases [C10]
Gender: Female, Male. Age: 18-64 years. Enrolment: 44.
Status: Ended. End date (EU): 2025-03-18. Decision date: 2024-10-14. Results received: No. Last updated: 2024-10-21.
Decision dates by country: BE: 2024-10-18, CZ: 2024-10-17, FR: 2024-10-17, ES: 2024-10-14, PL: 2024-10-21

Condition(s): Multiple Sclerosis (MS)

Source: https://euclinicaltrials.eu/ctis-public/view/2024-513639-26-00